EU clinical trial 2024-516770-29-00: ANISE-II; ANIfrolumab treatment for 24 weeks in patients with primary Sjögren’s syndrome – Efficacy and safety assessment in a randomized, double-blind, placebo-controlled phase-IIa proof-of-concept trial
Protocol code: ESR-21-21284
Sponsor: Universitair Medisch Centrum Groningen (Hospital/Clinic/Other health care facility). Phase: Therapeutic exploratory (Phase II). Countries: Netherlands (ended).
Therapeutic area(s): Diseases [C] - Immune System Diseases [C20]
Gender: Female, Male. Age: 18-64 years, 65+ years. Enrolment: 30.
Status: Ended. Start date (EU): 2022-10-09. End date (EU): 2025-08-21. Decision date: 2024-11-01. Results received: No. Last updated: 2024-11-01.

Condition(s): Sjogren's disease
Product: Saphnelo 300 mg concentrate for solution for infusion, Saphnelo placebo

Primary endpoint: The selected primary outcome measure is the Composite of Relevant Endpoints for Sjögren’s Syndrome (CRESS) response at week 24. The CRESS is a recently developed composite endpoint which consists of five clinically relevant items for pSS: a systemic disease activity, patient-reported symptoms, tear gland, salivary gland and serology item. A CRESS responder is someone who reached response on at least three out of five items.
Endpoint(s): Safety (adverse events and tolerability) of anifrolumab by monitoring SAE and AE, treatment discontinuation related to SAE and AE, and lab abnormalities at week 0, 4, 8, 12, 16, 20 and 24, Total CRESS response at week 12, Individual CRESS items (continuous): ClinESSDAI (weeks 0, 8, 12, 20, 24), ESSPRI (weeks 0, 8, 12, 20, 24), Schirmer's test (weeks 0, 12, 24), OSS (weeks 0, 12, 24), UWS (weeks 0, 12, 24), RF and total IgG concentration in blood (weeks 0, 8, 12, 20, 24), ESSDAI (continuous) (weeks 0, 4, 8, 12, 20, 24), The (Clin)ESSDAI minimal clinically important improvement (MCII, defined as decrease of ≥3 points) and low disease activity (LDA, defined as score<5) (weeks 8, 12, 20, 24), The ESSPRI MCII (defined as decrease of ≥1 point or ≥15%) and ESSPRI patient acceptable symptom state (PASS, defined as score <5) (weeks 8, 12, 20, 24), Physician GDA (weeks 0, 8, 12, 20, 24), DAS-28 (weeks 0, 8, 12, 20, 24), Patient GDA (weeks 0, 8, 12, 20, 24), NRS score oral, ocular, and vaginal dryness and mental fatigue (weeks 0, 8, 12, 20, 24), PASS question (weeks 0, 8, 12, 20, 24), EQ-5D measure of health-related quality of life (weeks 0, 8, 12, 20, 24), SF-36 health survey (weeks 0, 12, 24), MFI scale (weeks 0, 12, 24), FSFI in females (weeks 0, 12, 24), Raynaud questionnaire (weeks 0, 12, 24), SWS (weeks 0, 12, 24), SGUS OMERACT score (screening, 12, 24), SGUS OMERACT colour Doppler score (screening, 12, 24), Parotid gland histology at baseline vs. week 24: focus score and area fraction of CD45+ infiltrate, Serum levels of anti-SSA/-SSB, complement (C3/C4), lymphocyte count, and presence of cryoglobulinemia (weeks 0, 8, 12, 20, 24)

Source: https://euclinicaltrials.eu/ctis-public/view/2024-516770-29-00